EU clinical trial 2024-513669-38-00: RIISC Evaluation of low dose colchicine in prevention of ischemic stroke in patients with stroke due to atherosclerosis. Reducing inflammation in ischemic stroke with colchicine (riisc),
Protocol code: APHP211055
Sponsor: Assistance Publique Hopitaux De Paris (Hospital/Clinic/Other health care facility). Phase: Therapeutic confirmatory (Phase III). Countries: France (ongoing, recruiting).
Therapeutic area(s): Diseases [C] - Cardiovascular Diseases [C14]
Gender: Female, Male. Age: 18-64 years, 65+ years. Enrolment: 1400.
Status: Ongoing, recruiting. Start date (EU): 2023-05-17. Decision date: 2024-09-26. Results received: No. Last updated: 2026-04-10.

Condition(s): Stroke, Ischemic, TIA, Cardiac Disease, Atherosclerosis, Myocardial Infarction, Coronary Syndrome, Cerebral Infarction
Product: COLCHICINE OPOCALCIUM 1 mg, comprimé sécable

Primary endpoint: Composite of: nonfatal ischemic stroke or nonfatal hemorrhagic stroke or undetermined stroke, nonfatal myocardial infarction, urgent coronary or carotid revascularization following new symptoms, and vascular death including sudden death during the study (from 36 to 60 months)
Endpoint(s): Recurrent fatal and nonfatal ischemic stroke or urgent carotid revascularization following a new transient ischemic attack with negative neuro-imaging during the study, Recurrent fatal and nonfatal ischemic stroke during the study, Fatal and nonfatal myocardial infarction or urgent coronary revascularization following a new acute coronary syndrome during the study, Fatal and nonfatal myocardial infarction during the study, Vascular death during the study, Any stroke during the study, Any stroke or TIA during the study, Major coronary events (including MI) during the study, Any coronary end-points (MI, hospitalization for recurrent ACS, coronary revascularization procedure urgent or elective, fatal coronary event) during the study, Any death during the study, Fatal and non-fatal stroke with mRS>1, All revascularization procedures (coronary, carotid, peripheral) during the study, Carotid revascularization during the study

Source: https://euclinicaltrials.eu/ctis-public/view/2024-513669-38-00